EU clinical trial 2023-503630-44-00: A phase 3 multi-center trial to evaluate the efficacy and safety of tralokinumab in combination with topical corticosteroids in children (age 2 to <12 years) and infants (age 6 months to <2 years) with moderate-to-severe atopic dermatitis. The trial is randomized, double-blind, placebo-controlled, and parallel-group for children (age 2 to <12 years) and open label and single-group for infants (age 6 months to <2 years)
Protocol code: LP0162-1336
Sponsor: Leo Pharma A/S (Pharmaceutical company). Phase: Phase II and Phase III (Integrated). Countries: Poland (ongoing, recruitment ended), Belgium (ongoing, recruitment ended), Spain (ongoing, recruitment ended), Italy (ongoing, recruitment ended), Croatia (ongoing, recruitment ended), Denmark (ended), Romania (ongoing, recruitment ended), Germany (ongoing, recruitment ended), Netherlands (ongoing, recruitment ended), Ireland (ongoing, recruitment ended), Czechia (ended), Portugal (ended).
Therapeutic area(s): Diseases [C] - Skin and Connective Tissue Diseases [C17]
Gender: Female, Male. Age: 0-17 years. Enrolment: 112.
Start date (EU): 2024-11-20. Decision date: 2024-10-07. Results received: No. Last updated: 2026-07-23.
Decision dates by country: CZ: 2024-10-11, DK: 2024-10-07, PL: 2024-10-13, PT: 2024-10-09, RO: 2024-10-14, DE: 2024-10-10, NL: 2024-10-14, BE: 2024-10-11, ES: 2024-10-10, IE: 2024-10-11, IT: 2024-10-09, HR: 2024-10-14

Condition(s): Treatment of moderate-to-severe Atopic dermatitis
Product: The placebo presentation is a pre-filled syringe containing the same excipients in the same amounts as the IMP., Adtralza 150 mg solution for injection in pre-filled syringe

Primary endpoint: IGA 0/1 at Week 16, EASI75 at Week 16

Source: https://euclinicaltrials.eu/ctis-public/view/2023-503630-44-00